EU clinical trial 2023-509002-30-00: An Open-label, Single-group, Three-period, Fixed-sequence, Phase I Study to Assess the Pharmacokinetics of AZD6793 Tablets When Administered Alone and in Combination with Itraconazole Capsules in Healthy Adult Female and Male Participants
Protocol code: D7860C00004
Sponsor: AstraZeneca AB (Pharmaceutical company). Phase: Human Pharmacology (Phase I)- Other. Countries: Germany (ended).
Therapeutic area(s): Diseases [C] - Immune System Diseases [C20]; Diseases [C] - Respiratory Tract Diseases [C08]
Gender: Female, Male. Age: 18-64 years. Enrolment: 16.
Status: Ended. Start date (EU): 2024-06-25. End date (EU): 2024-10-05. Decision date: 2024-06-24. Results received: No. Last updated: 2024-06-24.

Condition(s): Chronic obstructive pulmonary disease

Source: https://euclinicaltrials.eu/ctis-public/view/2023-509002-30-00